EU clinical trial 2023-509335-60-00: A Phase 1 first in human study evaluating safety, pharmacokinetics and efficacy of ABBV-400 as monotherapy and in combination with bevacizumab in adult subjects with advanced solid tumors
Protocol code: M21-404
Sponsor: AbbVie Deutschland GmbH & Co. KG (Pharmaceutical company). Phase: Human Pharmacology (Phase I)- First administration to humans. Countries: Poland (ongoing, recruitment ended), France (ongoing, recruitment ended), Spain (ongoing, recruitment ended), Germany (ended).
Therapeutic area(s): Diseases [C] - Neoplasms [C04]
Gender: Female, Male. Age: 18-64 years, 65+ years. Enrolment: 177.
Start date (EU): 2023-02-23. Decision date: 2024-07-11. Results received: No. Last updated: 2026-07-27.
Decision dates by country: DE: 2024-07-19, FR: 2024-07-19, PL: 2024-08-04, ES: 2024-07-11

Condition(s): Advanced solid tumors including (but not limited to), non-small cell lung cancer (NSCLC), head and neck squamous cell carcinoma (HNSCC), gastric/gastroesophageal junction adenocarcinoma (GEA), colorectal cancer (CRC), and renal cell carcinoma (RCC)

Source: https://euclinicaltrials.eu/ctis-public/view/2023-509335-60-00